EU clinical trial 2022-501500-10-00: Impact of opioids on heart rate during rapid sequence intubation : Double-blind randomized controlled study (CANDY-CRASH).
Sponsor: Centre Hospitalier Sud Francilien (Hospital/Clinic/Other health care facility). Phase: Therapeutic use (Phase IV). Countries: France (ongoing, recruitment ended).
Therapeutic area(s): Analytical, Diagnostic and Therapeutic Techniques and Equipment [E] - Anesthesia and Analgesia [E03]
Gender: Female, Male. Age: 18-64 years, 65+ years. Enrolment: 150.
Status: Ongoing, recruitment ended. Start date (EU): 2023-05-16. Decision date: 2022-11-21. Results received: Yes. Last updated: 2022-11-21.

Condition(s): 55-65 years old patients with ASA > 3 or patients over 65 years old with any ASA,requiring rapid sequence induction considered to have a full stomach during the anesthesia consultation (scheduled or urgent).
Product: SODIUM CHLORIDE, SUFENTA 10 microgrammes/2 ml, solution injectable (I.V. ou péridurale), ULTIVA 2 mg, poudre pour solution injectable ou pour perfusion

Primary endpoint: Absolute variation of heart rate beats per minute between T0 (reference value at the entrance into the operating room) and T2 (end of induction and oro-tracheal intubation).
Endpoint(s): 1a- Cormack score in each group, 1b- Laryngoscopy of Macintosh® number for each group, 1c- Use of a long bent mandrel for each group, 2a- Percentage of patients with intraoperative vomiting at T2 for each group, 2b- Percentage of patients requiring vasopressor before T2, 2c- Percentage of patients with thoracic rigidity and/or bradycardia cardiac output < 50 beats per minute (bpm) at T2 for each group, 3a- Absolute and relative variations of +-20% in SAP/DAP and MAP between T0 and T2, 3b- Absolute and relative variations of +/- 20% in SAP/DAand MAP between T0 and T13, 3c- Relative variation of +/- 20% of HR between T0 and T2, 3d- Absolute and relative variations of +/- 20% of HR between T0 and T13.

Source: https://euclinicaltrials.eu/ctis-public/view/2022-501500-10-00